EU clinical trial 2023-505510-26-00: Preemptive Treament with acyclovir in intubated and mechanically ventilated patients with Herpes simplex virus oropharyngeal reactivation and one or less organ failure (PTH2)
Protocol code: APHP220800
Sponsor: Assistance Publique Hopitaux De Paris (Hospital/Clinic/Other health care facility). Phase: Therapeutic confirmatory (Phase III). Countries: France (ongoing, recruiting).
Therapeutic area(s): Analytical, Diagnostic and Therapeutic Techniques and Equipment [E] - Therapeutics [E02]
Gender: Female, Male. Age: 18-64 years, 65+ years. Enrolment: 246.
Status: Ongoing, recruiting. Start date (EU): 2024-06-19. Decision date: 2024-01-30. Results received: No. Last updated: 2026-01-07.
Decision dates by country: FR: 2024-04-19

Condition(s): Patients in ICU with invasive mechanical ventilation and HSV throat reactivation with 1 or no organ failures.
Product: ACICLOVIR VIATRIS 500 mg, poudre pour solution injectable (I.V.), CHLORURE DE SODIUM 0,9 % B. BRAUN, solution injectable en ampoule

Primary endpoint: Primary endpoint will be the mortality at day 60 post randomization
Endpoint(s): Day-90 mortality., Duration of mechanical ventilation and ventilator-free days at day 60., ICU length of stay and ICU-free days at day 60., Hospital length of stay and hospital-free days at day 60., SOFA score at days 1, 3, 5, 7, 10, 14, 21 and 28 post randomization., Incidence of HSV oral-labial lesions from randomization to day 28., Rate of patients with HSV positive in the throat at days 3, 7, 10, 14, 17, 21 and 28 post randomization., Rate of patients with HSV positive in tracheal aspirate at days 1, 7, 14, 21 and 28 post randomization., Rate of HSV bronchopneumonitis from randomization to day 60 post-randomization, Rate of acute respiratory distress syndrome (according to Berlin criteria) from randomization to day 60., Rate of bacterial ventilator-associated pneumonia from randomization to day 60., Rate of bacteremia from randomization to day 60., Glasgow coma score at days 1, 3, 5, 7, 10, and 14 post-randomization., Creatinine clearance at days 1, 3, 5, 7, 10, 14, 21 and 28 post randomization and need for renal replacement therapy and RRT free days from randomization to day 14 (acyclovir toxicity), Incidence of adverse event, severe adverse event at days 1, 3, 5, 7, 10, 14, 21 and 28 post randomization.

Source: https://euclinicaltrials.eu/ctis-public/view/2023-505510-26-00